EU clinical trial 2024-520025-36-00: A randomised, double-blind, comparative clinical trial of the effectiveness and tolerability of fentanyl in continuous parenteral perfusion versus on-demand bolus of morphine for the treatment of refractory dyspnoea in patients hospitalised for acute dec
Protocol code: ESTUDIO FEMODRIC
Sponsor: Fundacio Assistencial De Mutua De Terrassa Fpc (Hospital/Clinic/Other health care facility). Phase: Phase III and phase IV (Integrated). Countries: Spain (authorised, recruitment pending).
Therapeutic area(s): Diseases [C] - Cardiovascular Diseases [C14]
Gender: Female, Male. Age: 18-64 years. Enrolment: 28.
Status: Authorised, recruitment pending. Decision date: 2025-01-27. Results received: No. Last updated: 2025-01-27.

Condition(s): To evaluate the effectiveness and tolerability of fentanyl in PCSC, compared with the administration of morphine in BSC on demand, for the treatment of refractory dyspnea in patients hospitalized for acute decompensation of HF., Fentanyl [N-(1-fentanyl-4-piperidyl) propionanilide citrate (1:1)] is a synthetic opioid agonist developed in 1960. It has a rapid onset of action intravenously (<30 seconds) with a long half-life. between 2 and 4 hours and a duration of action between 30 and 60 minutes. It easily crosses the blood-brain barrier with an equilibrium between plasma and cerebrospinal fluid within 5 minutes of intravenous administration. Plasma levels decrease rapidly due to body redistribution, especially to fatty tissue, being metabolized in the liver to inactive metabolites; urinary excretion of unchanged fentanyl is less than 10% 34., Fentanyl [N-(1-fentanyl-4-piperidyl) propionanilide citrate (1:1)] is a synthetic opioid agonist developed in 1960. It has a rapid onset of action intravenously (<30 seconds) with a long half-life. between 2 and 4 hours and a duration of action between 30 and 60 minutes. It easily crosses the blood-brain barrier with an equilibrium between plasma and cerebrospinal fluid within 5 minutes of intravenous administration. Plasma levels decrease rapidly due to body redistribution, especially to fatty tissue, being metabolized in the liver to inactive metabolites; urinary excretion of unchanged fentanyl is less than 10% 34.
Product: FENTANYL, Fentanilo Medlink 50 microgramas/ml solução injetável

Primary endpoint: Reduction in the average daily intensity of dyspnea is the main criterion of effectiveness. The intensity of dyspnea is evaluated by the patient himself using a Verbal Numerical Scale (EVN) and a Visual Analogue Scale (VAS) of dyspnea 56. The effectiveness of the treatment is evaluated by comparing the EVN and VAS of dyspnea in the first evaluation or 0h with the EVN and VAS of dyspnea in the following consecutive evaluations or 24h, 48h and 72h.

Source: https://euclinicaltrials.eu/ctis-public/view/2024-520025-36-00